EU clinical trial 2024-516393-29-00: FECES - Fecal transplantation to Eradicate Colonizing Emergent Superbugs
Protocol code: APHP180587
Sponsor: Assistance Publique Hopitaux De Paris (Hospital/Clinic/Other health care facility). Phase: Therapeutic confirmatory (Phase III). Countries: France (authorised, recruiting).
Therapeutic area(s): Diseases [C] - Bacterial Infections and Mycoses [C01]
Gender: Female, Male. Age: 18-64 years, 65+ years. Enrolment: 299.
Status: Authorised, recruiting. Start date (EU): 2024-12-03. Decision date: 2024-12-03. Results received: No. Last updated: 2025-05-09.

Condition(s): Patients colonized with MDR-GNB
Product: Placebo double encapsulated oral transplant of fecal microbiota, Double encapsulated oral transplant of fecal microbiota

Primary endpoint: Proportion of subjects not carrying MDR-GNB (neither carbapenem-resistant Enterobacteriaceae [CRE] nor extended spectrum β-lactamase producing Enterobacteriaceae [ESBL-E]) at 30 ± 10 days after randomization, as determined by culture methods

Source: https://euclinicaltrials.eu/ctis-public/view/2024-516393-29-00